EU clinical trial 2024-519392-26-00: Acute appendicitis and microbiota – etiology and effects of the antimicrobial treatment - MAPPAC
Sponsor: Turku University Hospital (Hospital/Clinic/Other health care facility). Phase: Therapeutic use (Phase IV). Countries: Finland (authorised, recruitment pending).
Therapeutic area(s): Diseases [C] - Digestive System Diseases [C06]
Gender: Female, Male. Age: 18-64 years. Enrolment: 118.
Status: Authorised, recruitment pending. Decision date: 2024-11-26. Results received: No. Last updated: 2024-11-26.

Condition(s): Uncomplicated acute appendicitis, Complicated acute appendicitis
Product: LEVOFLOXACIN, ERTAPENEM, METRONIDAZOLE, MOXIFLOXACIN

Primary endpoint: The endpoint of the study is the microbial outcome, which is defined by evaluating the changes in the gut microbiota species variation. Determining the possible correlation of gut microbiota and complicated appendicitis will be performed by comparing the species variation.

Source: https://euclinicaltrials.eu/ctis-public/view/2024-519392-26-00